EU clinical trial 2024-512968-57-00: RESTART; Autologous Transplantation of Adult Salivary Gland Stem Cells to Restore Submandibular Gland Function after Radiotherapy
Sponsor: Universitair Medisch Centrum Groningen (Hospital/Clinic/Other health care facility). Phase: Human Pharmacology (Phase I)- First administration to humans. Countries: Netherlands (ongoing, recruiting).
Therapeutic area(s): Diseases [C] - Neoplasms [C04]
Gender: Female, Male. Age: 18-64 years, 65+ years. Enrolment: 18.
Status: Ongoing, recruiting. Start date (EU): 2024-11-01. Decision date: 2024-10-30. Results received: No. Last updated: 2024-10-30.

Condition(s): Patients operated with curative intend for head and neck cancer with an indication for bilateral postoperative radiotherapy, with or without chemotherapy.

Source: https://euclinicaltrials.eu/ctis-public/view/2024-512968-57-00